EU clinical trial 2024-514361-19-00: Ketamine infusion for symptomatological improvement of severe borderline personality disorder: a pilot study
Protocol code: RC31/23/0619
Sponsor: Centre Hospitalier Universitaire De Toulouse (Hospital/Clinic/Other health care facility). Phase: Therapeutic exploratory (Phase II). Countries: France (authorised, recruitment pending).
Therapeutic area(s): Psychiatry and Psychology [F] - Mental Disorders [F03]
Gender: Female, Male. Age: 18-64 years, 65+ years. Enrolment: 38.
Status: Authorised, recruitment pending. Decision date: 2024-10-18. Results received: No. Last updated: 2025-11-28.

Condition(s): borderline personality disorder
Product: KETAMINE RENAUDIN 10 mg/ml, solution injectable

Primary endpoint: Our primary outcome measures the difference of BPD symptoms’s intensity at BSL-23 (self-rated scale) from baseline to D9
Endpoint(s): Difference in the intensity of BPD symptoms measured by the BSL-23 scale between baseline and different times (H48, M1, M3), Difference in the intensity of BPD symptoms measured by the Zanarini-BPD scale between baseline and different times (H48, D9, M1, M3), Difference in the intensity of suicidal ideation measured by the C-SSRS scale between baseline and different times (H48, D9, M1, M3), Difference in the intensity of depressive symptoms measured by the MADRS scale between baseline and different times (H48, D9, M1, M3), a. Number of new hospitalizations in Psychiatry department (declarative measure, from D9 to M3) b. Number of visits to psychiatric emergencies (declarative measure, from D9 to M3), Collection of all serious and non-serious adverse events, in particular those attributed to ketamine

Source: https://euclinicaltrials.eu/ctis-public/view/2024-514361-19-00